EU clinical trial 2022-502176-23-01: A multicentre, triple blind, placebo controlled, parallel group study of atorvastatin in episodic migraine (StatinMigEpisodic)
Protocol code: StatinMigEpisodic
Sponsor: St. Olavs Hospital HF (Hospital/Clinic/Other health care facility). Phase: Therapeutic exploratory (Phase II). Countries: Norway (ongoing, recruiting).
Therapeutic area(s): Diseases [C] - Nervous System Diseases [C10]
Gender: Female, Male. Age: 18-64 years. Enrolment: 450.
Status: Ongoing, recruiting. Start date (EU): 2024-05-13. Decision date: 2023-06-23. Results received: No. Last updated: 2026-04-14.

Condition(s): Migraine
Product: ATORVASTATIN, PLACEBO

Primary endpoint: Difference between groups receiving atorvastatin 40 mg daily and placebo in change from baseline in number of migraine days per 4 weeks
Endpoint(s): Difference between groups receiving atorvastatin 40 mg daily and placebo in change from baseline in number of headache per 4 weeks, Difference in change from baseline between groups receiving atorvastatin 20 mg daily and placebo in number of days with headache per 4 weeks,, Number of responders (≥ 50% decrease in migraine days compared with baseline) between repectively Atorvastin 40 mg, Atorvastatin 20 mg and placebo

Source: https://euclinicaltrials.eu/ctis-public/view/2022-502176-23-01